EU clinical trial 2024-510718-34-00: Study of Artificial Intelligence-based Personalized Rituximab Treatment Protocol in Membranous nephropathy
Protocol code: 22-APN-01
Sponsor: Centre Hospitalier Universitaire De Nice (Hospital/Clinic/Other health care facility). Phase: Phase III and phase IV (Integrated). Countries: France (ongoing, recruiting).
Therapeutic area(s): Analytical, Diagnostic and Therapeutic Techniques and Equipment [E] - Therapeutics [E02]
Gender: Female, Male. Age: 18-64 years, 65+ years. Enrolment: 130.
Status: Ongoing, recruiting. Start date (EU): 2024-11-29. Decision date: 2024-09-09. Results received: No. Last updated: 2026-02-20.

Condition(s): Membranous nephropathy
Product: Truxima 500 mg concentrate for solution for infusion

Primary endpoint: Clinical remission (complete or partial) according to KDIGO or French guidelines: - Complete: urine protein/creatinine ratio (UPCR) <0.3 g/g and serum albumin>30 g/L - Partial: UPCR <3.5 g/g with a decrease >50% from baseline (i.e., at first rituximab infusion) and serum albumin improvement or normalization
Endpoint(s): Complete clinical remission at month-12 according to KDIGO or French guidelines, Partial clinical remission at month-12 according to KDIGO or French guidelines, Immunological remission: If membranous nephropathy anti-PLA2R1 associated: anti-PLA2R1 depletion (i.e., PLA2R1 titer < 14 RU/mL by ELISA EUROIMMUN kit) at month-3, month-6, month-12 ✓ If membranous nephropathy anti-THSD7A associated: anti-THSD7A depletion (i.e., positive or negative immunofluorescence), Percentage of change in urine protein/creatinine ratio (UPCR) (g/g) and urine albumin/creatinine ratio (mg/g) from day-0 to month-3, month-6, month-9, month-12, Percentage of change in serum creatinine (μmol/L) and Glomerular Filtration Rate estimated by CKD-EPI formula (mL/min/1.73m²) from day-0 to month-3, month-6, month-9, month-12, Percentage of change in anti-PLA2R1 titer (RU/mL) by ELISA (EUROIMMUN Kit) from day-0 to month-3, month-6, month-9, month-12 (membranous nephropathy anti-PLA2R1 associated only), Serum anti-rituximab antibodies (ng/mL) at month-3, month-6, month-9, month-12, Percentage of patients with serum rituximab (μg/mL) >2 μg/mL 3 months after the last infusion, Serious adverse events related to treatment during study follow-up, Modification of non-immunosuppressive anti-proteinuric treatment during study follow-up, Pharmacokinetics in all patients with serum creatinine and serum albumin levels, weight, anti- PLA2R1 and rituximab level at day-0, day-15, day-30, day-45, month-3, month-6, Correlation between epitope spreading at day-0 and response to treatment in both groups (in PLA2R1 and THSD7A positive patients)., Predictive rate (%) of the algorithm for rituximab underdosing (i.e. serum level <2 mg/ml at month-3) in the control group (i.e. patients treated according to the standard-of-care strategy)., Correlation between urine rituximab levels at day-15 and disease severity (defined as lowering of estimated glomerular filtration rate, proteinuria), drug exposure (measured with serum rituximab level), clinical response (partial or complete as defined above), immunological response (negative anti-PLA2R1 titer), Pharmacokinetics in all patients with serum creatinine and serum albumin levels, weight, anti- PLA2R1 and rituximab level at day-0, day-15 (predose and postdose), day-30, day-45, month-3, month-6, Immunophenotying of B cells subsets as follows: naïve cells (CD19+CD27-IgD+), non-switched memory cells (CD19+CD27+IgD+), switched memory cells (CD19+CD27+IgD-), double negative cells (CD19+CD27-IgD), transitional cells (CD19+CD38++CD27-IgD+) and plasmablasts (CD19+CD38++CD27+IgD-), expressed as the percentage of total lymphocytes., Immunophenotying of T cells subsets as follows: T helper cells (CD3+CD4+), cytotoxic T lymphocytes (CD3+ CD8+), regulatory T cells (CD3+ CD4+ Foxp3+ CD25high), Th1 cells (CD3+ CD4+ T-bet +) and Th17 cells (CD3+ CD4+ RORγt +)., Cytokine levels in pg/mL (IFN-γ, IFN-α, IL-12p70, IL-17A, IL-4, IL-5, IL-10, IL-1, IL-6) at day- 0 and month-6 (Nice patients only). 19. Optional: stools biorepository samples, Optional: stools biorepository samples will be collected at Day-0 and Month-6 visits for future exploratory biomarker analysis to better understand disease and the impact of the microbiota on the treatment response (Nice patients only).

Source: https://euclinicaltrials.eu/ctis-public/view/2024-510718-34-00